EU clinical trial 2024-511266-36-00: A phase I/IIa, dose-finding study to assess the safety and immunogenicity of an Orf virus-based COVID-19 vaccine booster (Prime-2-CoV_Beta) in healthy adults
Protocol code: PRiME2_21_1
Sponsor: Universitaetsklinikum Tuebingen AöR (Hospital/Clinic/Other health care facility). Phase: Phase I and Phase II (Integrated)- First administration to humans. Countries: Germany (ongoing, recruitment ended).
Therapeutic area(s): Diseases [C] - Virus Diseases [C02]
Gender: Female, Male. Age: 18-64 years. Enrolment: 96.
Status: Ongoing, recruitment ended. Start date (EU): 2026-03-26. Decision date: 2024-03-26. Results received: No. Last updated: 2026-04-13.

Condition(s): The clinical trial itself does not investigate a medical condition or disease. Rather, the safety and immunogenicity of a vaccine against SARS-CoV-2 infection is being investigated.

Source: https://euclinicaltrials.eu/ctis-public/view/2024-511266-36-00